EU clinical trial 2024-510764-23-00: A study in healthy people to compare two different Sifrol® tablets
Protocol code: 0248-0689
Sponsor: Boehringer Ingelheim International GmbH (Pharmaceutical company). Phase: Human Pharmacology (Phase I)- Bioequivalence Study. Countries: Germany (ended).
Therapeutic area(s): Not possible to specify
Gender: Female, Male. Age: 18-64 years. Enrolment: 28.
Status: Ended. Start date (EU): 2024-06-27. End date (EU): 2024-08-12. Decision date: 2024-05-31. Results received: No. Last updated: 2024-05-31.

Condition(s): Pharmacokinetic trial

Source: https://euclinicaltrials.eu/ctis-public/view/2024-510764-23-00